EU clinical trial 2024-518656-23-00: Neo-adjuvant Chemo and immunotherapy with durvalumab (MEDI4736) and tremelimumab (MEDI1123) In The pre-operAtive Treatment of locally advanced cholangIOcarciNoma: an exploratory and translational study.
Sponsor: IRCCS Istituto Nazionale Tumori Fondazione Pascale (Hospital/Clinic/Other health care facility). Phase: Therapeutic exploratory (Phase II). Countries: Italy (ongoing, recruiting).
Therapeutic area(s): Diseases [C] - Neoplasms [C04]
Gender: Female, Male. Age: 18-64 years, 65+ years. Enrolment: 38.
Status: Ongoing, recruiting. Start date (EU): 2023-09-01. Decision date: 2024-11-27. Results received: No. Last updated: 2025-12-05.

Condition(s): locally advanced cholangiocarcinoma
Product: TREMELIMUMAB, Gemcitabina Accord 100 mg/ml concentrato per soluzione per infusione., CISPLATINO Pfizer 50 mg/50 ml soluzione per infusione, DURVALUMAB

Primary endpoint: For the primary endpoint the proportion of CCA at 12 months after surgery will be computed along with an exact 90% confidence interval (CI). A one-sided exact test with a significance level of 0.05 will be performed assuming a H0 of the proportion of CCA at 12 months equal to 0.512. The safety analyses will be carried out on the SP. All the information necessary to identify the appearance of adverse events will be used in the analysis and summarized through descriptive statistics.
Endpoint(s): For secondary endpoints summary statistics will be calculated and reported along with 95% CI. Time-to event variables (PFS and OS) will be analyzed using the Kaplan-Meier product limit method (KM) and survival curves will be reported along with 95% CI.

Source: https://euclinicaltrials.eu/ctis-public/view/2024-518656-23-00